EU clinical trial 2025-524862-12-00: A single-center, randomized, single-blind, phase 4 study to evaluate the enhancement of mucosal immunity in infants through maternal vaccination during breastfeeding (MEALAC-01).
Sponsor: Universite Libre de Bruxelles (Educational Institution). Phase: Therapeutic use (Phase IV). Countries: Belgium (authorised, recruitment pending).
Therapeutic area(s): Diseases [C] - Virus Diseases [C02]
Gender: Female, Male. Age: 0-17 years, 18-64 years. Enrolment: 120.
Status: Authorised, recruitment pending. Decision date: 2026-04-14. Results received: No. Last updated: 2026-04-14.

Condition(s): Measles
Product: M-M-RvaxPro powder and solvent for suspension for injection Measles, mumps and rubella vaccine (live)

Primary endpoint: The level of binding antibodies against measles in breastmilk in vaccinated vs unvaccinated mothers, 5 times over 3 months.
Endpoint(s): Phenotype and activation of immune cells in breastmilk

Source: https://euclinicaltrials.eu/ctis-public/view/2025-524862-12-00